EU clinical trial 2024-520006-19-00: Multicenter clinical trial with medical device associated with a drug in an authorised therapeutic use for the treatment of CVNMI evaluating the efficacy and tolerability of the adyuvant treatment with EMDA-MMC versus standard BCG in patients with high grade CVNMI
Protocol code: CUETO1801
Sponsor: Presurgy S.L. (Pharmaceutical company). Phase: Therapeutic use (Phase IV). Countries: Spain (authorised, recruiting).
Therapeutic area(s): Diseases [C] - Neoplasms [C04]
Gender: Female, Male. Age: 18-64 years, 65+ years. Enrolment: 230.
Status: Authorised, recruiting. Start date (EU): 2021-12-15. Decision date: 2025-01-09. Results received: No. Last updated: 2025-10-09.

Condition(s): Non-muscle invasive bladder cancer
Product: MITOMYCIN

Primary endpoint: 5-year tumor recurrence rate. Defined as the percentage of pathologically confirmed urothelial carcinoma recurrences following transurethral resection (TUR) or biopsy, after a specified period of time during which the patient has remained disease-free. Recurrence rates will be compared between the two study groups.
Endpoint(s): Disease-free survival (DFS)., Tumor progression rate, defined as the percentage of patients who develop stage ≥ T2 disease., Tumor progression-free survival (PFS)., Overall survival., Adjuvant treatment completion rate., Cost-effectiveness evaluation of the use of the developed model for the follow-up of patients with high-grade NMIBC treated with adjuvant BCG or EMDA-MMC, Prospective and detailed recording of adverse events (AEs) and serious adverse events (SAEs)., Impact of adjuvant treatment on patient quality of life (FACT-BL, HADs, and Distress Thermometer).

Source: https://euclinicaltrials.eu/ctis-public/view/2024-520006-19-00